EU clinical trial 2023-509318-13-00: An open label, multi-center roll-over study to assess long-term safety in patients who are ongoing or have completed a prior global Novartis or GSK sponsored Tafinlar (dabrafenib) and/or Mekinist (trametinib) study and are judged by the investigator to benefit from continued treatment.
Protocol code: CDRB436X2X02B
Sponsor: Novartis Pharma AG (Pharmaceutical company). Phase: Therapeutic use (Phase IV). Countries: Austria (ongoing, recruiting), Hungary (ended), France (ongoing, recruiting), Germany (ongoing, recruiting), Spain (ongoing, recruiting), Netherlands (ongoing, recruiting), Denmark (ongoing, recruiting).
Therapeutic area(s): Diseases [C] - Neoplasms [C04]
Gender: Female, Male. Age: 0-17 years, 18-64 years, 65+ years. Enrolment: 28.
Start date (EU): 2018-01-15. Decision date: 2024-08-01. Results received: No. Last updated: 2026-05-26.
Decision dates by country: HU: 2024-08-01, NL: 2024-08-02, AT: 2024-08-12, FR: 2024-08-06, DE: 2024-08-07, ES: 2024-08-01, DK: 2024-08-06

Condition(s): Multiple indications
Product: TMT212, TMT212, Mekinist 0.5 mg film-coated tablets, Mekinist 2 mg film-coated tablets, DRB436, DRB436, DRB436, TMT212

Primary endpoint: Frequency and severity of AEs/SAEs.
Endpoint(s): Proportion of subjects with clinical benefit as assessed by the Investigator at scheduled visits.

Source: https://euclinicaltrials.eu/ctis-public/view/2023-509318-13-00